EU clinical trial 2023-510200-42-00: Double-blind, randomized, placebo-controlled, phase III study comparing norursodeoxycholic acid capsules with placebo in the treatment of primary sclerosing cholangitis
Protocol code: NUC-5/PSC
Sponsor: Dr. Falk Pharma GmbH (Pharmaceutical company). Phase: Therapeutic confirmatory (Phase III). Countries: Denmark (ended), Austria (ended), Norway (ended), Finland (ended), Poland (ended), Germany (ended), France (ended), Netherlands (ended), Hungary (ended).
Therapeutic area(s): Diseases [C] - Digestive System Diseases [C06]
Gender: Female, Male. Age: 0-17 years, 18-64 years, 65+ years. Enrolment: 195.
Status: Ended. Start date (EU): 2017-12-06. End date (EU): 2026-03-26. End date: 2026-03-27. Decision date: 2024-10-14. Results received: No. Last updated: 2026-05-05.
Decision dates by country: FI: 2024-10-21, FR: 2024-10-14, HU: 2024-10-14, DE: 2024-10-16, DK: 2024-10-21, AT: 2024-10-20, PL: 2024-11-18, NL: 2024-10-16, NO: 2024-10-21

Condition(s): primary sclerosing cholangitis (PSC)
Product: NUC01, Placebo to NUC01

Primary endpoint: Partial normalization of s-ALP and no worsening of disease stage as determined by the Ludwig stage.
Endpoint(s): Partial normalization of s-ALP and no worsening of disease stage as determined by the modified Nakanuma score at the week 96 visit compared to baseline as key secondary endpont. Liver stiffness, fibrosis stage, liver histology, dominant strictures, quality of life as other secondary endpoints.

Source: https://euclinicaltrials.eu/ctis-public/view/2023-510200-42-00